EU clinical trial 2025-521377-14-00: Clinical Randomised Phase 2 Trial of AP31969 versus Placebo for Rhythm Control of Atrial Fibrillation.
Protocol code: AP31969-M201
Sponsor: Acesion Pharma ApS (Pharmaceutical company). Phase: Therapeutic exploratory (Phase II). Countries: Hungary (ongoing, recruiting), Italy (ongoing, recruiting), Denmark (ongoing, recruiting), Bulgaria (ongoing, recruiting), Poland (ongoing, recruiting), Netherlands (ongoing, recruiting), Germany (ongoing, recruiting).
Therapeutic area(s): Diseases [C] - Cardiovascular Diseases [C14]
Gender: Female, Male. Age: 18-64 years, 65+ years. Enrolment: 180.
Status: Ongoing, recruiting. Start date (EU): 2025-10-06. Decision date: 2025-09-29. Results received: No. Last updated: 2026-07-27.
Decision dates by country: HU: 2025-10-02, IT: 2025-10-02, DK: 2025-09-29, DE: 2025-10-01, BG: 2025-11-06, PL: 2025-10-06, NL: 2025-10-22

Condition(s): Atrial fibrillation
Product: AP31969, The placebo tablets contain the same excipient as in the active IMP, but without AP31969. All tablet strengths containing AP31969 as well as placebo tablets are visually identical., AP31969, AP31969, AP31969

Primary endpoint: AF burden from week 2 to week 12.
Endpoint(s): • Number of AF episodes from week 2 to week 12 • Mean duration of AF episodes from week 2 to week 12 • Time to first AF episode > 5 hours (for participants in sinus rhythm [SR] at randomisation) • Time to first symptomatic AF episode (for participants in sinus rhythm [SR] at randomisation), • Change from baseline in Modified European Heart Rhythm Association (mEHRA) score at week 12, • Change from baseline in Atrial Fibrillation Effect on QualiTy-of-Life (AFEQT) questionnaire at week 12 • Change from baseline in EQ-5D-5L score at week 12 • Patient Global Assessment of Change (PGI-C) score at week 12, • Adverse events (AE) • Number of ventricular tachycardia episodes > 30 seconds of duration from week 0 to week 12 • Change from baseline in QTcF at week 12

Source: https://euclinicaltrials.eu/ctis-public/view/2025-521377-14-00